EU clinical trial 2024-514732-24-00: Toward personalized medicine to guide drug withdrawal in children with juvenile idiopathic arthritis in clinical remission: a randomized clinical trial comparing early versus late drug withdrawal combining imaging and multi-Omics.
Protocol code: Re-JIA
Sponsor: IRCCS Istituto Giannina Gaslini (Hospital/Clinic/Other health care facility). Phase: Therapeutic use (Phase IV). Countries: Belgium (authorised, recruitment pending), Italy (ongoing, recruiting), Portugal (authorised, recruitment pending), Lithuania (authorised, recruitment pending), Spain (authorised, recruitment pending), Denmark (not authorised), Czechia (authorised, recruitment pending).
Therapeutic area(s): Diseases [C] - Immune System Diseases [C20]
Gender: Female, Male. Age: 0-17 years, 18-64 years. Enrolment: 328.
Start date (EU): 2025-04-28. Decision date: 2024-10-29. Results received: No. Last updated: 2025-08-26.
Decision dates by country: BE: 2024-10-31, DK: 2024-10-29, IT: 2024-10-30, CZ: 2024-10-31, ES: 2024-10-29, PT: 2024-10-29, LT: 2024-10-29

Condition(s): Juvenile idiopathic arthritis
Product: Humira 40 mg solution for injection in pre-filled pen, ORENCIA 125 mg solution for injection in pre-filled syringe, Enbrel 50 mg solution for injection in pre-filled syringe, Reumaflex 50 mg/ml soluzione iniettabile, siringa preriempita, ORENCIA 250 mg powder for concentrate for solution for infusion, Cosentyx 150 mg solution for injection in pre-filled syringe, Enbrel 25 mg solution for injection in pre-filled syringe, Simponi 45 mg/0.45 mL solution for injection in pre-filled pen., Jylamvo 2 mg/ml oral solution, Olumiant 2 mg film-coated tablets, Humira 40 mg solution for injection in pre-filled syringe, Olumiant 1 mg film-coated tablets, RoActemra 162 mg solution for injection in pre-filled pen., RoActemra 20 mg/mL concentrate for solution for infusion, Cosentyx 75 mg solution for injection in pre-filled syringe, XELJANZ 5 mg film-coated tablets, Reumaflex 50 mg/ml soluzione iniettabile, siringa preriempita, Reumaflex 50 mg/ml soluzione iniettabile, siringa preriempita, RoActemra 20 mg/mL concentrate for solution for infusion, Cosentyx 150 mg solution for injection in pre-filled pen, Olumiant 4 mg film-coated tablets, Enbrel 25 mg solution for injection in pre-filled pen, Methotrexate 2,5 mg film-coated tablets, XELJANZ 1 mg/mL oral solution, Simponi 50 mg solution for injection in pre-filled pen., Simponi 50 mg solution for injection in pre-filled syringe., RoActemra 20 mg/mL concentrate for solution for infusion, Reumaflex 50 mg/ml soluzione iniettabile, siringa preriempita, Enbrel 50 mg solution for injection in pre-filled pen, Reumaflex 50 mg/ml soluzione iniettabile, siringa preriempita, Reumaflex 50 mg/ml soluzione iniettabile, siringa preriempita, Humira 20 mg solution for injection in pre-filled syringe, Reumaflex 50 mg/ml soluzione iniettabile, siringa preriempita, Reumaflex 50 mg/ml soluzione iniettabile, siringa preriempita

Primary endpoint: Rate of flares: the rate of patients who experience disease flare at any time throughout the study period will be compared between the two arms.
Endpoint(s): Time to Flare: time from randomization to flare

Source: https://euclinicaltrials.eu/ctis-public/view/2024-514732-24-00